EU clinical trial 2022-502281-25-00: A Randomized, Double-blind, Placebo-Controlled, Multicenter Phase 3 Study to Evaluate the Safety, Tolerability, and Efficacy of XEN1101 as Adjunctive Therapy in Focal-Onset Seizures
Protocol code: XPF-010-302
Sponsor: Xenon Pharmaceuticals Inc. (Pharmaceutical company). Phase: Therapeutic confirmatory (Phase III). Countries: Bulgaria (ongoing, recruitment ended), Italy (ended), Spain (ongoing, recruiting), Croatia (ongoing, recruiting), Portugal (ongoing, recruiting), Czechia (ongoing, recruiting), Austria (ongoing, recruiting), Hungary (ongoing, recruitment ended), Poland (ongoing, recruiting), Germany (ongoing, recruiting), Netherlands (ongoing, recruiting), France (ongoing, recruiting), Belgium (ongoing, recruiting), Finland (ongoing, recruiting).
Therapeutic area(s): Diseases [C] - Nervous System Diseases [C10]
Gender: Female, Male. Age: 18-64 years, 65+ years. Enrolment: 197.
Start date (EU): 2023-09-27. Decision date: 2023-05-12. Results received: No. Last updated: 2026-04-10.
Decision dates by country: FI: 2024-11-19, BE: 2024-06-18, CZ: 2023-05-12, ES: 2023-05-16, HR: 2023-05-18, HU: 2023-05-18, AT: 2023-05-17, DE: 2024-06-24, PT: 2023-05-15, IT: 2023-05-15, PL: 2023-05-22, BG: 2023-05-22, NL: 2024-06-19, FR: 2024-06-13

Condition(s): Focal Onset Seizures
Product: XPF-010, XEN1101 placebo drug product consists of a size 3 white opaque HPMC capsule (Capsugel VCaps® Plus White OP) containing 10mg of Avicel® PH102 (microscrystaline cellulose), XPF-010, XPF-010, XPF-010

Primary endpoint: Proportion of subjects experiencing ≥50% reduction in monthly (28 days) focal seizure frequency from baseline through the DBP for XEN1101 versus placebo
Endpoint(s): MPC in monthly (28 days) focal seizure frequency from baseline through the DBP for XEN1101 versus placebo, Proportion of subjects experiencing ≥50% reduction in weekly (7 days) focal seizure frequency from baseline to Week 1., Proportion of subjects experiencing “at least much improved” (including “much” and “very much improved”) in PGIC at Week 12.

Source: https://euclinicaltrials.eu/ctis-public/view/2022-502281-25-00